EU clinical trial 2023-507204-31-00: A Phase 3 Double-Blind Study to Evaluate the Long-Term Safety and Efficacy of Povorcitinib in Participants With Moderate to Severe Hidradenitis Suppurativa
Protocol code: INCB 54707-312
Sponsor: Incyte Corp. (Pharmaceutical company). Phase: Therapeutic confirmatory (Phase III). Countries: Italy (ongoing, recruitment ended), Austria (ended), Poland (ongoing, recruitment ended), France (ongoing, recruitment ended), Germany (ongoing, recruitment ended), Bulgaria (ongoing, recruitment ended), Denmark (ongoing, recruitment ended), Netherlands (ongoing, recruitment ended), Belgium (ended), Greece (ongoing, recruitment ended), Spain (ongoing, recruitment ended), Czechia (ongoing, recruitment ended).
Therapeutic area(s): Diseases [C] - Immune System Diseases [C20]
Gender: Female, Male. Age: 18-64 years, 65+ years. Enrolment: 703.
Start date (EU): 2024-07-26. Decision date: 2024-05-13. Results received: No. Last updated: 2025-11-21.
Decision dates by country: IT: 2024-05-14, CZ: 2024-05-15, BE: 2024-05-15, PL: 2024-05-20, DK: 2024-05-13, FR: 2024-05-17, AT: 2024-05-21, ES: 2024-05-14, BG: 2024-05-20, GR: 2024-05-20, NL: 2024-05-14, DE: 2024-05-15

Condition(s): Hidradenitis Suppurativa
Product: Povorcitinib, Povorcitinib

Primary endpoint: Proportion of participants with treatment-emergent adverse events (TEAEs).
Endpoint(s): Proportion of participants with serious TEAEs., Proportion of participants with serious TEAEs leading to study drug discontinuation., Proportion of participants who achieve HiSCR at each visit. − HiSCR is defined as at least a 50% reduction from baseline of parent study in the total AN count, with no increase from baseline of parent study in abscess or draining tunnel count., Proportion of participants who achieve HiSCR75 at each visit. − HiSCR75 is defined as at least a 75% reduction from baseline of parent study in the total AN count, with no increase from baseline of parent study in abscess or draining tunnel count., Proportion of participants who achieve HiSCR90 at each visit. − HiSCR90 is defined as at least a 90% reduction from baseline of parent study in the total AN count, with no increase from baseline of parent study in abscess or draining tunnel count., Proportion of participants who achieve HiSCR100 at each visit. − HiSCR100 is defined as a 100% reduction from baseline of parent study in the total AN count, with no increase from baseline of parent study in abscess or draining tunnel count., Proportion of participants with flare at each visit. − Flare is defined as at least a 25% increase in AN count with a minimum increase of 2 Ans relative to Week 54., Time to first flare., Mean change from baseline of parent study in HiSQoL score at each visit. − The HiSQoL is a 17-item, HS-specific, health-related QoL instrument with a 7‐day recall period. The HiSQoL total score ranges from 0 to 68, with higher scores indicating higher disease impact on QoL., Mean change from baseline of parent study in DLQI at each visit. − The DLQI is a skin disease–specific questionnaire aimed at the evaluation of how the disease affects health-related QoL. The DLQI total score ranges from 0 to 30 with higher scores indicating higher skin disease impact on QoL., Proportion of participants with no increase in AN count relative to Week 54 at each visit., Proportion of participants with no increase in ANdT count relative to Week 54 at each visit. − ANdT count is defined as the total sum of abscess, inflammatory nodule, and draining tunnel., Proportion of participants with no increase in draining tunnel count relative to Week 54 at each visit., Proportion of participants with a total AN count of 0, 1, or 2 at each visit., Proportion of participants with a total ANdT count of 0, 1, or 2 at each visit.

Source: https://euclinicaltrials.eu/ctis-public/view/2023-507204-31-00